EU clinical trial 2023-509901-57-00: A TWO-PART, OPEN-LABEL SYSTEMIC GENE DELIVERY STUDY TO EVALUATE THE SAFETY AND EXPRESSION OF RO7494222 (SRP‑9001) IN SUBJECTS UNDER THE AGE OF FOUR WITH DUCHENNE MUSCULAR DYSTROPHY
Protocol code: BN43881
Sponsor: F. Hoffmann-La Roche AG (Pharmaceutical company). Phase: Therapeutic exploratory (Phase II). Countries: Italy (ongoing, recruitment ended), Belgium (ongoing, recruitment ended), Germany (ongoing, recruitment ended), France (ongoing, recruitment ended), Spain (ongoing, recruitment ended).
Therapeutic area(s): Diseases [C] - Musculoskeletal Diseases [C05]
Gender: Male. Age: 0-17 years. Enrolment: 11.
Status: Ongoing, recruitment ended. Start date (EU): 2026-08-03. Decision date: 2024-08-06. Results received: No. Last updated: 2026-08-06.
Decision dates by country: FR: 2024-08-09, BE: 2024-08-08, DE: 2024-08-13, ES: 2024-08-06, IT: 2024-09-23

Condition(s): Duchenne Muscular Dystrophy
Product: Delandistrogene moxeparvovec-rokl

Primary endpoint: Incidence of treatment-emergent adverse events, Incidence of serious adverse events, Incidence of adverse events of special interest, Clinically significant changes in vital signs and physical examination findings, Clinically significant changes in safety laboratory assessments, ECGs, and ECHOs
Endpoint(s): Change in quantity of SRP-9001-dystrophin protein expression from baseline to Week 12 as measured by Western blot

Source: https://euclinicaltrials.eu/ctis-public/view/2023-509901-57-00